EU clinical trial 2022-502822-41-00: C4971006: A PHASE 1b/2, OPEN-LABEL STUDY OF PF-07901801 IN COMBINATION WITH GLOFITAMAB AFTER A FIXED, SINGLE DOSE OF OBINUTUZUMAB IN PARTICIPANTS WITH RELAPSED/REFRACTORY DIFFUSE LARGE B CELL LYMPHOMA NOT ELIGIBLE FOR STEM CELL TRANSPLANTATION
Protocol code: C4971006
Sponsor: Pfizer Inc. (Pharmaceutical company). Phase: Phase I and Phase II (Integrated)- Other. Countries: Spain (ended), France (ended), Germany (ended).
Therapeutic area(s): Diseases [C] - Hemic and Lymphatic Diseases [C15]
Gender: Female, Male. Age: 18-64 years, 65+ years. Enrolment: 34.
Status: Ended. End date (EU): 2025-08-01. End date: 2026-04-09. Decision date: 2025-04-30. Results received: No. Last updated: 2025-04-30.
Decision dates by country: FR: 2025-04-30, DE: 2025-04-30, ES: 2025-04-30

Condition(s): Relapsed/Refractory Diffuse Large B Cell Lymphoma
Product: Columvi 10 mg concentrate for solution for infusion, Gazyvaro 1,000 mg concentrate for solution for infusion., Maplirpacept

Primary endpoint: Phase 1b: DLTs during the DLT observation period (21 days following Cycle 1 Day 1), Phase 2: OR per Lugano Response Classification Criteria 2014 as assessed by the investigator.
Endpoint(s): Phase 1b: AEs as characterized by type, frequency, severity (as graded by NCI CTCAE v5.0), timing, seriousness, and relationship to study treatment. Laboratory abnormalities as characterized by type, frequency, severity (as graded by NCI CTCAE v5.0), and timing. The severity of CRS and ICANS as assessed according to ASTCT criteria., Phase 1b: OR, DoR, CR, DoCR, and PFS per Lugano Response Classification Criteria 2014 as assessed by the investigator., Phase 1b: Pre- and post-dose concentrations of PF-07901801., Phase 1b: ADAs and NAbs against PF-07901801., Phase 2: DoR, CR, DoCR, and PFS by investigator in participants with measurable disease by investigator per Lugano Response Classification Criteria 2014., Phase 2: AEs as characterized by type, frequency, severity (as graded by NCI CTCAE V5.0), timing, seriousness, and relationship to study treatment. Laboratory abnormalities as characterized by type, frequency, severity (as graded by NCI CTCAE v5.0), and timing. The Severity of CRS and ICANS will be assessed according to ASTCT criteria., Phase 2: Pre- and post-dose concentrations of PF-07901801., Phase 2: ADAs and NAbs against PF-07901801.

Source: https://euclinicaltrials.eu/ctis-public/view/2022-502822-41-00